EU clinical trial 2023-509346-35-00: A Phase 1/2, Multicenter, Open-label, and Dose-escalation Study of ACP-196 in Subjects with Chronic Lymphocytic Leukemia, Richter's Syndrome or Prolymphocytic Leukemia
Protocol code: ACE-CL-001
Sponsor: Acerta Pharma B.V. (Pharmaceutical company). Phase: Phase I and Phase II (Integrated)- Other. Countries: Italy (ongoing, recruitment ended).
Therapeutic area(s): Diseases [C] - Neoplasms [C04]
Gender: Female, Male. Age: 18-64 years, 65+ years. Enrolment: 1.
Status: Ongoing, recruitment ended. Start date (EU): 2015-05-26. Decision date: 2024-09-23. Results received: No. Last updated: 2026-07-29.

Condition(s): Richter's Syndrome, Chronic Lymphocytic Leukemia, Prolymphocytic Leukemia
Product: Calquence 100 mg hard capsules, Calquence 100 mg film-coated tablets

Primary endpoint: Efficacy Parameters • Overall response rate • Duration of response • Progression-free survival (with a subgroup analysis by sex, male vs female for overall response rate, duration of response), Safety Parameters • DLTs and MTD • Frequency, severity, and attribution of adverse events (AEs), Pharmacokinetic and Pharmacodynamic Parameters The occupancy of BTK by acalabrutinib will be measured in peripheral blood mononuclear cells (PBMCs) with the aid of a biotin-tagged acalabrutinib analogue probe. The effect of acalabrutinib on biologic markers of B-cell function will also be evaluated

Source: https://euclinicaltrials.eu/ctis-public/view/2023-509346-35-00